EU clinical trial 2026-525464-18-00: Safety and Tolerability of REGN17235 in Adult Participants with Clonal Cytopenia of Undetermined Significance and Low-Risk Myelodysplastic Syndrome with SF3B1 Mutation
Protocol code: R17235-HM-24125
Sponsor: Regeneron Pharmaceuticals Inc. (Pharmaceutical company). Phase: Human Pharmacology (Phase I)- First administration to humans. Countries: Belgium (authorised, recruitment pending).
Therapeutic area(s): Diseases [C] - Neoplasms [C04]
Gender: Female, Male. Age: 18-64 years, 65+ years. Enrolment: 15.
Status: Authorised, recruitment pending. Decision date: 2026-06-22. Results received: No. Last updated: 2026-06-22.

Condition(s): Clonal Cytopenia of Undetermined Significance with SF3B1 mutation, Low-Risk Myelodysplastic Syndrome with SF3B1 mutation

Source: https://euclinicaltrials.eu/ctis-public/view/2026-525464-18-00